EU clinical trial 2025-523106-32-00: A Phase III, Randomized, Double-Blind, Placebo-Controlled, Parallel Group Study to Evaluate the Efficacy and Safety of Once-Weekly RO7795068 Administered to Participants With Obesity or Overweight and Type 2 Diabetes
Protocol code: WC45726
Sponsor: F. Hoffmann-La Roche AG (Pharmaceutical company). Phase: Therapeutic confirmatory (Phase III). Countries: Germany (ongoing, recruiting), Romania (authorised, recruiting), Czechia (ongoing, recruiting), Poland (ongoing, recruiting), Hungary (not authorised), France (ongoing, recruiting), Spain (ongoing, recruiting), Italy (ongoing, recruiting).
Therapeutic area(s): Diseases [C] - Nutritional and Metabolic Diseases [C18]
Gender: Female, Male. Age: 18-64 years, 65+ years. Enrolment: 551.
Start date (EU): 2026-05-25. Decision date: 2026-05-13. Results received: No. Last updated: 2026-05-18.
Decision dates by country: CZ: 2026-05-18, FR: 2026-05-13, DE: 2026-05-13, HU: 2026-05-15, IT: 2026-05-13, RO: 2026-05-18, ES: 2026-05-13, PL: 2026-05-15

Condition(s): Obesity or Overweight and Type 2 Diabetes
Product: RO7795068, RO7795068, RO7795068 Placebo, RO7795068, RO7795068, RO7795068, RO7795068

Primary endpoint: Percent (%) change from baseline in body weight at Week 72
Endpoint(s): Achieve ≥5% body weight loss at Week 72 (Yes/No), Achieve ≥10% body weight loss at Week 72 (Yes/No), Achieve ≥15% body weight loss at Week 72 (Yes/No), Change from baseline in body weight (kg) at Week 72, Change from baseline in HbA1c at Week 72, Achieve HbA1c of ≤ 6.5% at Week 72 (Yes/No), Achieve HbA1c of <7% at Week 72 (Yes/No), Change from baseline in waist circumference (cm) at Week 72, Change from baseline in fasting glucose at Week 72, Change from baseline in fasting insulin at Week 72, Change from baseline in LDL cholesterol at Week 72, Change from baseline in HDL cholesterol at Week 72, Change from baseline in triglyceride at Week 72, Change from baseline in systolic blood pressure at Week 72, Change from baseline in physical functioning as assessed by physical functioning domain of Short Form (36) Health Survey Version 2 Acute Form (SF-36v2 Acute Form) at Week 72, Change from baseline in physical functioning composite as assessed by Impact of Weight on Quality of Life-Lite Clinical Trials Version (IWQoL-Lite-CT) at Week 72, Change from baseline in waist-to-hip ratio at Week 72, Change from baseline in waist-to-height ratio at Week 72, Change from baseline in Control of Eating Questionnaire (CoEQ) subscale scores for craving control, positive mood, craving for savory and craving for sweet; and the individual hunger item score at Week 72, Change from baseline on symptoms and impact of urinary incontinence as assessed by International Consultation on Incontinence Questionnaire-Urinary Incontinence Short Form (ICIQ-UI SF) at Week 72, Experience no change, improvement, or worsening in Patient Global Impression of Change (PGI-C) Urinary Incontinence at Week 72, Experience no change, improvement, or worsening in Patient Global Impression of Severity/Status (PGI-S) Urinary Incontinence at Week 72, Experience no change, improvement, or worsening in PGI-C Physical Functioning at Week 72, Experience no change, improvement, or worsening in PGI-S Physical Functioning at Week 72, Change from baseline in HRQoL as assessed by SF-36v2 Acute Form domain scores and component summary scores at Week 72, Change from baseline in HRQoL as assessed by Impact of Weight on Quality of Life-Lite Clinical Trials Version (IWQoL-Lite-CT) domain scores and total score at Week 72, Change from baseline at Week 72 in non-HDL cholesterol, Change from baseline at Week 72 in VLDL cholesterol, Change from baseline at Week 72 in total cholesterol, Change from baseline at Week 72 in free fatty acids, Change from baseline at Week 72 in diastolic blood pressure, Change from baseline at Week 72 in high-sensitivity C-reactive protein (hsCRP), Change from baseline in urinary albumin/creatinine ratio at Week 72, Achieve ≥ 15% body weight loss at Week 72 (Yes/No), Change from baseline in BMI at Week 72, Percent change from baseline in weight by obesity class, at Week 72, Time to achieve ≥5%, ≥10% and ≥15% weight loss from baseline through Week 72 (weeks), Achieve HbA1c of < 5.7% at Week 72 (Yes/No), Incidence and severity of adverse events (AEs) (including SAEs, AESIs and AEs leading to study drug discontinuation), with severity determined according to mild/moderate/severe criteria, Change from baseline in selected safety laboratory values, vital signs, and ECGs through Week 72, Changes from baseline in Columbia-Suicide Severity Rating Scale (C-SSRS) and the Patient Health Questionnaire-9 (PHQ-9) through Week 72

Source: https://euclinicaltrials.eu/ctis-public/view/2025-523106-32-00